EU clinical trial 2023-509591-42-00: A randomized, 2-arm, open-label, phase II study of abemaciclib combined with endocrine therapy (letrozole or fulvestrant) with or without a short course of induction chemotherapy with paclitaxel as first-line therapy in patients with unresectable locally advanced or metastatic HR-positive/HER2-negative breast cancer with aggressive disease criteria. (ABIGAIL)
Protocol code: ABIGAIL
Sponsor: Medica Scientia Innovation Research S.L. (Pharmaceutical company). Phase: Therapeutic exploratory (Phase II). Countries: Spain (ended), Portugal (ended), Italy (ended).
Therapeutic area(s): Diseases [C] - Neoplasms [C04]
Gender: Female, Male. Age: 18-64 years, 65+ years. Enrolment: 162.
Status: Ended. Start date (EU): 2021-05-04. End date (EU): 2025-06-30. Decision date: 2024-11-26. Results received: Yes. Last updated: 2025-06-12.
Decision dates by country: IT: 2024-12-09, PT: 2024-11-26, ES: 2024-12-10

Condition(s): HR-positive/HER2-negative breast cancer
Product: FULVESTRANT, ABEMACICLIB, LETROZOLE, PACLITAXEL

Primary endpoint: 12-week ORR, defined as complete response (CR) or partial response (PR), during the first 12 weeks of treatment as per independent blinded central review, using Response Evaluation Criteria in Solid Tumors (RECIST) version (v) 1.1.
Endpoint(s): ORR in both study arms, defined as the number of patients who experience a CR or PR divided by the number of patients in the analysis set. Tumor response will be defined as per investigator assessment and per independent blinded central review, using RECIST v1.1 criteria;, CBR in both study arms, defined as the number of patients with an objective response (CR or PR), or stable disease (for at least 24 weeks) divided by the number of patients in the analysis set. Tumor response will be defined as per investigator assessment and blinded independent central review using RECIST v1.1 criteria;, 12-week PFS rate in both study arms, defined as the proportion of patients with disease progression or death from any cause, whichever occurs first during the first 12 weeks from randomization, as per investigator assessment and blinded independent central review using RECIST v1.1 criteria;, PFS in both study arms, defined as the period of time from randomization to the first occurrence of disease progression or death from any cause, whichever occurs first, as per investigator assessment and blinded independent central review using RECIST v1.1 criteria;, TTR in both study arms, defined as the time from randomization to time of the first objective tumor response (tumor shrinkage of ≥30%) observed in patients who achieved a CR or PR, as per investigator assessment and blinded independent central review using RECIST v1.1 criteria;, DoR in both study arms, defined as the time from the first occurrence of a documented objective response to disease progression or death from any cause, whichever occurs first, as per investigator assessment and per blinded independent central review using RECIST v1.1 criteria;, OS in both study arms, defined as the time from randomization to death from any cause as per investigator assessment and blinded independent central review using RECIST v1.1 criteria. Patients without documented death at the time of the final analysis will be censored at the date of the last follow-up. We will analyze 1- and 2-year survival probability. These are defined as the probability of survival at 1 and 2 years after the date of treatment initiation based on the Kaplan-Meier estimate;, MTS in both study arms, defined as the best percentage of changes from baseline in the size of target tumor lesions (the biggest decrease, or smallest increase if no decrease will be observed), as determined per investigator assessment and blinded independent central review using RECIST v1.1 criteria, TFST in both study arms, defined as the time from randomization to the time a patient starts his/her first-line treatment (first subsequent therapy);, TSST in both study arms, defined as the time from randomization to the time a patient starts his/her second-line treatment (second subsequent therapy);, TFC in both study arms, defined as the time from randomization to the time a patient included in Arm A starts his/her first-line chemotherapy;, Incidence of adverse events (AEs) in both study arms as assessed by the investigator, with severity determined through the use of USA National Cancer Institute’s Common Terminology Criteria for Adverse Events version 5.0 (NCI- CTCAE v 5.0);, Overall change from baseline in patient-reported global QoL in both study arms, general health status, functioning and symptoms; time to deterioration in global QoL; and time to deterioration in pain;, Exploratory: Mutation profiling, copy number variability, gene expression, multiplex assays, proteomic analyses, digital pathology, immunohistochemistry, taxonomic or functional analyses may be performed on tissue, blood, and stool samples to investigate the potential association with clinical outcomes, safety, and tolerability profile., Exploratory: Association of treatment efficacy and/or safety outcomes in all patients with radiological imaging biomarkers.

Source: https://euclinicaltrials.eu/ctis-public/view/2023-509591-42-00